EU clinical trial 2025-525127-27-00: A Double-Blind, Randomized, Placebo-Controlled Study to Investigate the Safety and Efficacy of Aritinercept, a Dual BAFF/APRIL Inhibitor, in Patients with Generalized Myasthenia Gravis
Protocol code: AUR-200-2024-02
Sponsor: Aurinia Pharmaceuticals Inc. (Pharmaceutical company). Phase: Phase I and Phase II (Integrated)- Other. Countries: Poland (ongoing, recruiting).
Therapeutic area(s): Diseases [C] - Immune System Diseases [C20]
Gender: Female, Male. Age: 18-64 years, 65+ years. Enrolment: 28.
Status: Ongoing, recruiting. Start date (EU): 2026-06-08. Decision date: 2026-05-15. Results received: No. Last updated: 2026-07-31.

Condition(s): Generalized Myasthenia Gravis
Product: AUR200, Isotone Natriumchloridlösung 0,9 % Braun Injektionslösung

Primary endpoint: Phase 1: Incidence of treatment-emergent adverse events; Phase 2: Change from baseline in Myasthenia Gravis Activities of Daily Living (MG-ADL) total score
Endpoint(s): Aritinercept serum concentrations over time, Change from baseline in serum levels of IgG, IgM and IgA, Incidence of aritinercept anti-drug antibodies

Source: https://euclinicaltrials.eu/ctis-public/view/2025-525127-27-00